EU clinical trial 2025-523051-64-00: A multicenter, double-blind, randomized, placebo-controlled, parallel-group, twelve-week treatment proof-of-concept trial to explore the efficacy and safety of IDOR-1117-2520 in adults with moderate to severe chronic plaque psoriasis with or without psoriatic arthritis.
Protocol code: ID-091A201
Sponsor: Idorsia Pharmaceuticals Ltd. (Pharmaceutical company). Phase: Therapeutic exploratory (Phase II). Countries: Romania (ongoing, recruitment ended), Bulgaria (ended).
Therapeutic area(s): Diseases [C] - Immune System Diseases [C20]; Diseases [C] - Skin and Connective Tissue Diseases [C17]
Gender: Female, Male. Age: 18-64 years, 65+ years. Enrolment: 18.
Start date (EU): 2026-01-26. Decision date: 2026-01-07. Results received: No. Last updated: 2026-07-14.
Decision dates by country: BG: 2026-01-07, RO: 2026-01-12

Condition(s): Moderate to severe chronic plaque psoriasis
Product: IDOR-1117-2520 matching placebo

Primary endpoint: Change from baseline to Week 12 in Psoriasis Area and Severity Index (PASI) score.
Endpoint(s): • Achievement of static physician’s global assessment (sPGA) score clear (0), almost clear (1) and ≥ 2 points improvement from baseline to each time point up to Week 12. • Change from baseline and ratio to baseline at each time point up to Week 16 in sPGA score., • Adverse events (AEs) leading to premature discontinuation of trial intervention. • Treatment-emergent AEs and serious adverse events (SAEs). • Change from baseline to each time point in: - Vital signs - Body weight - Clinical laboratory variables - 12-lead electrocardiogram (ECG) • Treatment-emergent marked abnormalities for: - Vital signs - Clinical laboratory variables - 12-lead ECG

Source: https://euclinicaltrials.eu/ctis-public/view/2025-523051-64-00